EU clinical trial 2023-505024-62-01: Fractionated stereotactic radiotherapy plus second-generation antiandrogen for oligometastatic patients with castration-resistant prostate cancer. Phase II Spanish study, prospective, multicenter. (OLIGORESIST)
Protocol code: IRA-RAD-2022-001
Sponsor: Instituto de investigación en Oncología radioterápica FEOR (Fundación Española de Oncología RT) (Educational Institution). Phase: Therapeutic exploratory (Phase II). Countries: Spain (ongoing, recruiting).
Therapeutic area(s): Diseases [C] - Neoplasms [C04]; Diseases [C] - Male Urogenital Diseases [C12]
Gender: Male. Age: 18-64 years, 65+ years. Enrolment: 51.
Status: Ongoing, recruiting. Start date (EU): 2024-05-16. Decision date: 2023-10-09. Results received: No. Last updated: 2026-04-16.

Condition(s): Oligometastatic patients with castration-resistant prostate cancer
Product: Xtandi - 80 mg film-coated tablets, Abiraterona Normon 500 mg comprimidos revestidos por película

Primary endpoint: Radiological progression by choline PET/CT or 68Ga-PSMA PET/CT, in patients with mCRPC treated with the combination of second-generation antiandrogen plus SBRT.
Endpoint(s): Overall survival (time from initiation of second-generation antiandrogen to exitus) in patients with mCRPC treated with the combination of second-generation antiandrogen plus SBRT., Quality of life of these patients using the European Organization for Research and Treatment of Cancer (EORTC) quality QLQ-C30, validated for oncology patients. of life scale, EORTC ., Acute and chronic toxicity according to the "Common Terminology Criteria for Adverse Events" (CTCAEv5.0) scale.

Source: https://euclinicaltrials.eu/ctis-public/view/2023-505024-62-01